EU clinical trial 2023-506248-18-00: A PHASE 1/2 STUDY OF REGN5093 IN PATIENTS WITH MET-ALTERED ADVANCED NON-SMALL CELL LUNG CANCER
Sponsor: Regeneron Pharmaceuticals Inc. (Pharmaceutical company). Phase: Phase I and Phase II (Integrated)- First administration to humans. Countries: France (ended).
Therapeutic area(s): Diseases [C] - Neoplasms [C04]
Gender: Female, Male. Age: 18-64 years, 65+ years. Enrolment: 35.
Status: Ended. Start date (EU): 2020-01-07. End date (EU): 2025-03-04. Decision date: 2024-06-14. Results received: No. Last updated: 2024-06-14.

Condition(s): MET-altered non-small cell lung cancer (NSCLC)
Product: REGN5093

Primary endpoint: Phase 1: Number of patients with Dose Limiting Toxicities, Phase 1: Incidence and severity of treatment-emergent adverse events, Phase 1: Incidence and severity of adverse events of special interest (AESIs), Phase 1: Incidence and severity of serious adverse events (SAEs), Phase 1: Incidence and severity of grade ≥3 laboratory abnormalities, Phase 1: REGN5093 concentrations in serum over time, Phase 2: Objective response rate (ORR) per RECIST 1.1
Endpoint(s): Phase 1: ORR per RECIST 1.1, Phase 2: Incidence and severity of TEAEs, Phase 2: Incidence and severity of AESIs, Phase 2: Incidence and severity of SAEs, Phase 2: Incidence and severity of grade ≥3 laboratory abnormalities, Phase 2: REGN5093 Pharmacokinetics (PK), Phase 2: REGN5093 concentrations in serum over time, Phase 1 and 2: Duration of response (DOR) per RECIST 1.1., Phase 1 and 2: Disease control rate (DCR) per RECIST 1.1., Phase 1 and 2: Progression free survival (PFS) per RECIST 1.1., Phase 1 and 2: Overall survival (OS), Phase 1 and 2: Immunogenicity as measured by Anti-drug antibodies (ADA) to REGN5093

Source: https://euclinicaltrials.eu/ctis-public/view/2023-506248-18-00